EU clinical trial 2022-502442-27-00: A Phase 3, randomised, double-blind, parallel-group, event-driven, cardiovascular safety study with BI 456906 administered subcutaneously compared with placebo in participants with overweight or obesity with established cardiovascular disease (CVD) or chronic kidney disease, and/or at least two weight-related complications or risk factors for CVD
Protocol code: 1404-0040
Sponsor: Boehringer Ingelheim International GmbH, Boehringer Ingelheim Espana S.A., Boehringer Ingelheim RCV GmbH & Co. KG (Pharmaceutical company). Phase: Therapeutic confirmatory (Phase III). Countries: Italy (ended), Norway (ended), Germany (ended), Greece (ended), Netherlands (ended), Denmark (ended), Belgium (ended), Slovakia (ended), Ireland (ended), Portugal (ended), Poland (ended), Austria (ended), Bulgaria (ended), Spain (ended), Czechia (ended), Hungary (ended), Finland (ended).
Therapeutic area(s): Diseases [C] - Nutritional and Metabolic Diseases [C18]
Gender: Female, Male. Age: 18-64 years, 65+ years. Enrolment: 2042.
Status: Ended. Start date (EU): 2024-01-08. End date (EU): 2026-06-17. End date: 2026-06-30. Decision date: 2023-12-12. Results received: No. Last updated: 2026-07-14.
Decision dates by country: ES: 2024-01-08, FI: 2024-01-09, GR: 2023-12-18, DK: 2023-12-12, IE: 2024-01-12, BE: 2023-12-18, AT: 2024-01-15, NO: 2023-12-19, HU: 2024-01-12, DE: 2023-12-15, BG: 2024-01-15, NL: 2023-12-18, CZ: 2024-01-09, SK: 2023-12-22, PL: 2023-12-21, IT: 2023-12-14, PT: 2024-01-09

Condition(s): Obesity
Product: Placebo, BI 456906, BI 456906, BI 456906, BI 456906, BI 456906, BI 456906, BI 456906

Primary endpoint: Time to first occurrence of any of the adjudicated components of the composite endpoint consisting of: CV death, non-fatal stroke, non-fatal MI, ischaemia related coronary revascularisation, or HFE (this includes hospitalisation for heart failure [HHF], emergency room visit, urgent care visit, or urgent outpatient HF visit) (5P-MACE)
Endpoint(s): Time to first occurrence of any of the adjudicated components of the composite endpoint consisting of: CV death, non-fatal stroke, or non-fatal MI (3P-MACE), Absolute change in SBP (mmHg) from baseline to Week 72, Absolute change in waist circumference (cm) from baseline to Week 72, Absolute change in KCCQ-TSS from baseline to Week 72 in trial participants with HF at baseline, Time to first occurrence of any of the adjudicated components of the composite endpoint consisting of: CV death, non-fatal stroke, non-fatal MI, ischaemia related coronary revascularisation, or HFE (this includes HHF, emergency room visit, urgent care visit, or urgent outpatient HF visit) (5P-MACE), Percentage change in body weight from baseline to Week 72, Absolute change in DBP (mmHg) from baseline to Week 72, Absolute change in AST (U/L) from baseline to Week 72, Absolute change in ALT (U/L) from baseline to Week 72, Absolute change in HbA1c (mmol/mol) from baseline to Week 72 in trial participants with T2DM, Absolute change in HbA1c (%) from baseline to Week 72 in trial participants with T2DM, Time to onset of T2DM in trial participants without T2DM at baseline, Time to first occurrence of any of the adjudicated components of the composite endpoint consisting of: CV death, non-fatal stroke, non-fatal MI, or ischaemia related coronary revascularisation (4P-MACE), Time to first occurrence of any of the adjudicated components of the composite endpoint consisting of: CV death, non-fatal stroke, non-fatal MI, or HFE (3PMACE+ HFE), Time to first occurrence of any of the adjudicated components of the composite endpoint consisting of: CV death, non-fatal stroke, or non-fatal MI (3P-MACE), Time to first occurrence of adjudicated CV death or adjudicated HFE, Time to first occurrence of adjudicated CV death or adjudicated HHF, Time to first occurrence of adjudicated HFE, Time to adjudicated CV death, Time to all-cause mortality, Time to first occurrence of adjudicated non-fatal MI, Time to first occurrence of adjudicated non-fatal stroke, Time to first occurrence of adjudicated ischaemia related coronary revascularisation, Body weight reduction ≥5% from baseline to Week 72, Body weight reduction ≥10% from baseline to Week 72, Body weight reduction ≥15% from baseline to Week 72, A composite of death, number of adjudicated HFEs (including HHFs, urgent HF visits, and unplanned outpatient visits), time to first adjudicated HFE and change from baseline in KCCQ-TSS at 72 weeks of treatment assessed by the win ratio in trial participants with HF at baseline

Source: https://euclinicaltrials.eu/ctis-public/view/2022-502442-27-00